EU clinical trial 2023-507115-35-00: A Phase III, Open-label, Single Arm, Prospective, Multicenter Study to Assess Efficacy and Safety of Kedrion Intravenous Human Normal Immunoglobulin (IVIg) 10% in Adult Patients with Chronic Immune Thrombocytopenia (ITP)
Protocol code: KB072
Sponsor: Kedrion S.p.A. (Pharmaceutical company). Phase: Therapeutic confirmatory (Phase III). Countries: Germany (authorised, recruitment pending), Spain (ongoing, recruiting), Czechia (authorised, recruitment pending), Italy (authorised, recruitment pending), Romania (ongoing, recruiting).
Therapeutic area(s): Diseases [C] - Immune System Diseases [C20]
Gender: Female, Male. Age: 18-64 years, 65+ years. Enrolment: 24.
Start date (EU): 2025-11-03. Decision date: 2025-04-30. Results received: No. Last updated: 2026-05-05.
Decision dates by country: IT: 2025-04-30, RO: 2025-05-05, CZ: 2025-04-30, DE: 2025-04-30, ES: 2025-04-30

Condition(s): Chronic Immune Thrombocytopenia (ITP)
Product: KIg10

Primary endpoint: The rate of participants with response (R), defined as participants with a platelet count > 30 × 109/L and at least a 2-fold increase of the baseline count, confirmed during the evaluation period on at least 2 separate occasions at least 7 days apart, and absence of bleeding during the evaluation period.
Endpoint(s): 1.Number and rate of participants with: a.CR: PLT > 100x109/L on 2 occasions at least 7 days apart and no bleeding b. loss of CR or R: PLT <100x109/L or bleeding ( CR) or PLT <30x109/L or < 2-fold increase of baseline or bleeding (R) c.Nonresponders (NR), 2.Time to response, 3. Response Duration, 4. Hemorrhages regression of, 5. maximum PLT count achieved, 6.Time to maximum PLT count, 7.Bleedings (timing/grade)

Source: https://euclinicaltrials.eu/ctis-public/view/2023-507115-35-00